EU clinical trial 2024-515479-36-00: AITIK-Discontinuation of TyrosIne Kinase Inhibitors (ITK) in Chronic Myeloid Leukemia (LMC) and Impact on the Immune System: a Randomized Comparative Study of Two Therapeutic Strategies
Protocol code: AITIK
Sponsor: Centre Hospitalier Universitaire De Poitiers (Hospital/Clinic/Other health care facility). Phase: Therapeutic confirmatory (Phase III). Countries: France (ongoing, recruitment ended).
Therapeutic area(s): Diseases [C] - Hemic and Lymphatic Diseases [C15]
Gender: Female, Male. Age: 18-64 years, 65+ years. Enrolment: 170.
Status: Ongoing, recruitment ended. Start date (EU): 2023-07-05. Decision date: 2024-08-20. Results received: No. Last updated: 2025-06-05.

Condition(s): Chronic Myeloid Leukemia
Product: SPRYCEL 50 mg film-coated tablets, Tasigna 200 mg hard capsules, Tasigna 150 mg hard capsules, Glivec 100 mg film-coated tablets, SPRYCEL 20 mg film-coated tablets, Bosulif 100 mg film-coated tablets

Primary endpoint: Proportion (%) of patients in TFR 24 months after discontinuation in the dose maintenance then discontinuation arm and in the dose deescalation then discontinuation arm.
Endpoint(s): 1-Recording of adverse events and scoring according to CTCAE V5 grades, 2.8-Collection of EQ-5D5 and FACT-Leu32, 3-Proportion (%) of patients losing their MMR, 4.7-Proportion (%) of patients losing their DMR, 5-Quantitative analysis: difference in the proportions, at randomisation and 12 months post-randomisation, of innate CD8 LTs within total CD8 LTs, 6-Evaluation of the residual plasma concentration of the TKI in ng/mL, 9-After loss of DMR during the treatment phase: collection of the prescribed TKI and its daily dosage (mg per day) as well as the time (in months) between the loss of DMR and its re-obtainment; after loss of MMR during the discontinuation phase: collection of the time (in months) between the loss of MMR and its re-obtainment, 10- Quantitative analysis: proportions of CD8i LTs in total CD8 LTs, 11- Quantitative analysis: proportions of innate CD8 LTs in total CD8 LTs

Source: https://euclinicaltrials.eu/ctis-public/view/2024-515479-36-00